EU clinical trial 2023-504418-30-00: A Randomized, Double-Blind, Placebo-Controlled, Phase 2 Study to Investigate the Efficacy and Safety of MBS2320 in Patients With Idiopathic Pulmonary Fibrosis (IPF)
Protocol code: IST-07
Sponsor: Modern Biosciences Limited (Pharmaceutical company). Phase: Therapeutic exploratory (Phase II). Countries: France (ended), Spain (ended), Italy (ended), Germany (ended), Greece (ended), Hungary (ended).
Therapeutic area(s): Diseases [C] - Bacterial Infections and Mycoses [C01]; Diseases [C] - Respiratory Tract Diseases [C08]
Gender: Female, Male. Age: 18-64 years, 65+ years. Enrolment: 156.
Status: Ended. Start date (EU): 2023-10-24. End date (EU): 2024-03-14. Decision date: 2023-09-26. Results received: No. Last updated: 2023-12-05.
Decision dates by country: DE: 2023-09-29, IT: 2023-10-02, GR: 2023-09-26, ES: 2023-09-27, HU: 2023-09-28, FR: 2023-09-26

Condition(s): Idiopathic Pulmonary Fibrosis
Product: Placebo matches MBS2320 Capsules 40mg, MBS2320

Primary endpoint: Change from baseline in FVC versus placebo up to Week 12 or up to the point of discontinuation
Endpoint(s): Change from baseline in %FVC up to Week 12, Change from baseline in %DLCO up to Week 12, Change from baseline up to Week 12 in primary and secondary endpoints, Time to first acute exacerbation up to week 12. Change from baseline in KCO and AV up to week 12, Change from baseline in FEV and FEV/FVC ration at week 4,8 and 12. Change from baseline in SF-36, KBKILD and L-PF at weeks 4,8 and 12, Proportion of participants with evidence of disease progression, defined as a decline in %FVC ≥10%, decline in %DLCO ≥15%, lung transplantation, or death.

Source: https://euclinicaltrials.eu/ctis-public/view/2023-504418-30-00